EU clinical trial 2024-512086-14-00: A Double-Blind, Randomized, Placebo-Controlled Study to Evaluate the Efficacy and Safety of Odevixibat (A4250) in Children with Biliary Atresia Who Have Undergone a Kasai Hepatoportoenterostomy (BOLD)
Protocol code: A4250-011
Sponsor: Ipsen Pharma (Pharmaceutical company). Phase: Therapeutic confirmatory (Phase III). Countries: Hungary (ended), Belgium (ended), France (ended), Spain (ended), Poland (ended), Germany (ended), Italy (ended), Netherlands (ended).
Therapeutic area(s): Diseases [C] - Congenital, Hereditary, and Neonatal Diseases and Abnormalities [C16]
Gender: Female, Male. Age: 0-17 years. Enrolment: 80.
Status: Ended. Start date (EU): 2020-09-23. End date (EU): 2026-06-01. End date: 2026-06-22. Decision date: 2024-07-11. Results received: No. Last updated: 2026-06-04.
Decision dates by country: BE: 2024-07-11, HU: 2024-07-15, ES: 2024-07-12, FR: 2024-08-26, PL: 2024-07-15, DE: 2024-07-12, NL: 2024-07-11, IT: 2024-08-05

Condition(s): Biliary Atresia
Product: A4250, Placebo, odevixibat matching hard white opaque capsules filled with pellets with no active treatment for oral administration, A4250

Primary endpoint: The primary efficacy endpoint is the time from randomization to first occurrence of liver transplant, or death, during the 104 week treatment period.
Endpoint(s): 1. Proportion of patients who are alive and have not undergone a liver transplant after 104 weeks., 2. Time to onset of first sentinel event during the 104-week treatment period. Sentinel events are defined in the protocol, 3. Total bilirubin level after 13, 26, 52, and 104 weeks., 4. Serum bile acid level after 13, 26, 52, and 104 weeks., 5. Time to pediatric end-stage liver disease (PELD) score ≥15., 6. Safety parameters including AEs, SAEs, findings on physical examination, laboratory assessments (including fat-soluble vitamins and lipids) and abdominal ultrasound.

Source: https://euclinicaltrials.eu/ctis-public/view/2024-512086-14-00